EU clinical trial 2023-507108-30-00: A phase II, national, multicenter, uncontrolled and open trial to evaluate the feasibility and safety of lamparoscopic administration of allogenic mesenchymals stem cell (adMSC) extracted by lipoaspirate from healthy patients, for the treatment of patients with inflammatory bowel strictures associated with Crohn's disease. SM
Protocol code: FJD-MEIC-21-01
Sponsor: Instituto De Investigacion Sanitaria Fundacion Jimenez Diaz (Laboratory/Research/Testing facility). Phase: Therapeutic exploratory (Phase II). Countries: Spain (ended).
Therapeutic area(s): Diseases [C] - Digestive System Diseases [C06]
Gender: Female, Male. Age: 18-64 years, 65+ years. Enrolment: 20.
Status: Ended. Start date (EU): 2022-10-22. End date (EU): 2024-12-13. Decision date: 2023-07-28. Results received: Yes. Last updated: 2024-03-18.

Condition(s): Crohn's disease
Product: ALLOGENEIC ADIPOSE TISSUE-DERIVED MESENCHYMAL STEM CELLS EXPANDED

Primary endpoint: proportion and type of complications arising from treatment (adverse reactions) Complications during anesthesia, Complications arising from the treatment administration procedure
Endpoint(s): To evaluate the change in the length of the stenosis with respect to the basal in the enteroresonance., To evaluate the change in the CDAI questionnaire score from baseline at 6, 12, 18, 24, 36 and 52 weeks., To assess the change in score from baseline on the IBDQ32 questionnaire at 6, 12, 18, 24, 24, 36 and 52 weeks after treatment, Describe the number of patients with obstructive episode who required resection surgery during the study period.

Source: https://euclinicaltrials.eu/ctis-public/view/2023-507108-30-00